EU clinical trial 2022-502673-41-01: A Multicenter, Randomized, Double-blind, Placebo-Controlled Phase II Study to Investigate the Efficacy and Safety of CYP-001 in Combination with Corticosteroids vs Corticosteroids Alone for the Treatment of High-Risk Acute Graft Versus Host Disease
Protocol code: CYP-GVHD-P2-01
Sponsor: Cynata Therapeutics Limited (Pharmaceutical company). Phase: Therapeutic exploratory (Phase II). Countries: Spain (ended), France (ended), Lithuania (ended), Italy (ended).
Therapeutic area(s): Diseases [C] - Immune System Diseases [C20]
Gender: Female, Male. Age: 18-64 years, 65+ years. Enrolment: 38.
Status: Ended. Start date (EU): 2024-07-29. End date (EU): 2026-06-17. End date: 2026-06-18. Decision date: 2024-03-11. Results received: No. Last updated: 2026-02-04.
Decision dates by country: ES: 2024-03-11, LT: 2024-03-15, IT: 2024-03-18, FR: 2024-03-15

Condition(s): High-Risk Acute Graft Versus Host Disease
Product: Placebo

Primary endpoint: Overall Response Rate at Day 28 is defined as the proportion of participants in each treatment arm demonstrating a complete response (CR; resolution of aGvHD signs and symptoms) or a partial response (PR; an improvement in the severity of GvHD by at least one grade compared to baseline) without requirement for additional systemic therapies for an earlier progression, a mixed response or a lack of response.
Endpoint(s): Proportion of all subjects in each treatment arm with durable overall response (OR) defined as patients with OR (CR or PR) at Day 28 and maintain an OR at Day 60 and Day 100; Proportion of all subjects in each treatment arm with OR defined as subjects with complete response (CR) or partial response (PR) at Day 7, Day 14, Day 21, Day 60 and Day 100; Proportion of all subjects in each treatment arm with CR at Day 28, Day 60 and Day 100, Overall Survival (OS) is defined as the time from date of randomization to the date of death due to any cause, Event-Free survival (EFS) is defined as the time from the date of randomization (baseline) to the date of hematologic disease relapse/progression, graft failure, or death due to any cause., Time to Non-Relapse Mortality (NRM) is defined as the time from the date of randomization (baseline) to the date of death not preceded by hematologic disease relapse/progression., Failure Free Survival (FFS) is defined as the time from the date of randomization (baseline) to date of hematologic disease relapse/progression, non-relapse mortality, or addition of new systemic aGvHD treatment; Hematologic disease Relapse/Progression is defined as the time from the date of randomization (baseline) to the date to hematologic disease (malignant or non-malignant) relapse/progression., cGvHD is defined as the diagnosis of mild, moderate, or severe cGvHD, Weekly cumulative steroid dose for each subject up to Day 100 or end of treatment will be calculated, Changes in Patient Reported Outcomes (PRO), To evaluate the incidence, severity, duration of TEAE, changes from baseline in hematology, biochemistry, coagulation profile

Source: https://euclinicaltrials.eu/ctis-public/view/2022-502673-41-01